EU clinical trial 2025-522128-28-00: Study Investigating Tucatinib and Osimertinib Pharmacokinetics in Primary and Metastatic Brain Tumors: the STICK trial
Sponsor: Amsterdam UMC Stichting (Patient organisation/association). Phase: Human Pharmacology (Phase I)- Other. Countries: Netherlands (authorised, recruiting).
Therapeutic area(s): Diseases [C] - Neoplasms [C04]
Gender: Female, Male. Age: 18-64 years, 65+ years. Enrolment: 20.
Status: Authorised, recruiting. Start date (EU): 2026-05-26. Decision date: 2025-10-15. Results received: No. Last updated: 2026-02-25.

Condition(s): Breast cancer, Non small cell lung carcinoma, Glioblastoma

Source: https://euclinicaltrials.eu/ctis-public/view/2025-522128-28-00